EU clinical trial 2025-522936-14-00: A randomized, double-blind, placebo-controlled, multicentre trial, assessing the impact of ferric carboxymaltose on exercise capacity and functional status in pulmonary hypertension (IRON-PH)
Protocol code: Z-2025090
Sponsor: Ziekenhuis Oost Limburg (Hospital/Clinic/Other health care facility). Phase: Therapeutic use (Phase IV). Countries: Belgium (ongoing, recruiting).
Therapeutic area(s): Diseases [C] - Cardiovascular Diseases [C14]
Gender: Female, Male. Age: 18-64 years, 65+ years. Enrolment: 306.
Status: Ongoing, recruiting. Start date (EU): 2026-01-27. Decision date: 2025-12-12. Results received: No. Last updated: 2026-05-11.
Decision dates by country: BE: 2026-02-26

Condition(s): Pulmonary hypertension, Iron deficiency
Product: Ferric carboxymaltose 50 mg iron/ml solution for injection/infusion, SODIUM CHLORIDE

Primary endpoint: Change in 6MWD from baseline to 24 weeks follow-up
Endpoint(s): Change in EQ5D from baseline to 24 weeks follow-up, Change in MLHFQ from baseline to 24 weeks follow-up, Change in FSS from baseline to 24 weeks follow-up, The hazard ratio between treatment arms in developing a composite clinical worsening event in the overall trial population (from first patient visit to last patient visit)

Source: https://euclinicaltrials.eu/ctis-public/view/2025-522936-14-00